EU clinical trial 2022-501263-41-00: A single arm, open-label study to evaluate the efficacy and safety of ABBV-668 in subjects with moderate to severe ulcerative colitis.
Protocol code: M21-446
Sponsor: Abbvie Deutschland GmbH & Co. KG (Pharmaceutical company). Phase: Therapeutic exploratory (Phase II). Countries: Belgium (ended), France (ended), Poland (ended).
Therapeutic area(s): Diseases [C] - Digestive System Diseases [C06]
Gender: Female, Male. Age: 18-64 years, 65+ years. Enrolment: 36.
Status: Ended. Start date (EU): 2023-08-10. End date (EU): 2024-12-05. End date: 2024-12-23. Decision date: 2023-07-19. Results received: Yes. Last updated: 2025-03-10.
Decision dates by country: BE: 2023-07-19, FR: 2023-07-21, PL: 2023-11-10

Condition(s): Ulcerative Colitis
Product: ABBV-668

Primary endpoint: The primary endpoint is the achievement of endoscopic improvement (Mayo ESS of 0 or 1) at Week 8.
Endpoint(s): The estimands corresponding to the secondary efficacy objectives are: For each binary secondary endpoint specified in Section 3.3: The difference in the proportion of subjects achieving a response in ABBV-668 treatment group in the ITT Population versus in historical placebo group, where subjects will be counted as non-responders after the start of rescue medication (initiation or dose escalation of UC-related corticosteroids)., Achievement of clinical remission per Adapted Mayo score at Week 8., Achievement of clinical response per Adapted Mayo score at Week 8., Achievement of clinical response per Partial Adapted Mayo score at Week 8., Achievement of endoscopic remission at Week 8.

Source: https://euclinicaltrials.eu/ctis-public/view/2022-501263-41-00